EU clinical trial 2022-502282-24-00: A Multicenter, Open-label, Long-term, Safety, Tolerability, and Efficacy Study of XEN1101 in Subjects Diagnosed With Epilepsy (X-TOLE4)
Protocol code: XPF-010-304
Sponsor: Xenon Pharmaceuticals Inc. (Pharmaceutical company). Phase: Therapeutic confirmatory (Phase III). Countries: Spain (ongoing, recruiting), Portugal (ongoing, recruiting), Czechia (ongoing, recruiting), Hungary (ongoing, recruiting), Poland (ongoing, recruiting), Italy (ongoing, recruiting), Austria (ongoing, recruiting), Croatia (ongoing, recruiting), Bulgaria (ongoing, recruiting), Belgium (ongoing, recruiting), France (ongoing, recruiting), Germany (ongoing, recruiting), Netherlands (authorised, recruitment pending), Finland (ongoing, recruiting), Latvia (ended), Ireland (ongoing, recruiting).
Therapeutic area(s): Diseases [C] - Nervous System Diseases [C10]
Gender: Female, Male. Age: 0-17 years, 18-64 years, 65+ years. Enrolment: 446.
Start date (EU): 2024-02-14. Decision date: 2023-10-03. Results received: No. Last updated: 2026-07-10.
Decision dates by country: PT: 2023-10-04, PL: 2023-10-09, DE: 2024-07-01, AT: 2023-10-09, CZ: 2023-10-05, HU: 2023-10-09, BE: 2024-07-09, BG: 2023-10-09, IE: 2025-01-10, LV: 2025-01-23, IT: 2023-10-06, FI: 2024-12-09, NL: 2024-07-09, FR: 2024-07-25, HR: 2023-10-09, ES: 2023-10-03

Condition(s): Focal-onset Seizures, Primary generalized tonic-clonic seizures
Product: XPF-010, XPF-010, XPF-010, XPF-010

Primary endpoint: Severity and frequency of TEAEs, SAEs, AESIs, AEDCs, AEs leading to dose reduction, and ECIs; potentially clinically significant changes in vital signs, clinical laboratory findings, and/or 12-lead ECG; changes in ophthalmologic exams; increase in suicide risk as assessed by the C-SSRS; clinically significant changes in urological symptoms (including retention) as measured by the AUA-SI; and growth and development in adolescents assessed via physical exam and endocrine laboratory assessments.
Endpoint(s): Percent change in monthly seizure rate recorded at baseline (in the antecedent studies) compared to each 4-week assessment period in the treatment period in X-TOLE4., Proportion of responders (subjects experiencing ≥50% reduction in seizure frequency from baseline) in each consecutive 4-week assessment period of the treatment period of the OLE study, Change in CGI‑S and PGI-S scores over time., Change in the QOLIE-31 over time.

Source: https://euclinicaltrials.eu/ctis-public/view/2022-502282-24-00